EU clinical trial 2024-512203-40-00: A Phase 2 Study to Evaluate Efficacy, Safety and Tolerability of VIR-2218 and VIR-3434 in Participants with Chronic Hepatitis D Virus Infection (SOLSTICE)
Protocol code: VIR-CHDV-V201
Sponsor: Vir Biotechnology Inc. (Pharmaceutical company). Phase: Therapeutic exploratory (Phase II). Countries: France (ongoing, recruitment ended), Romania (ongoing, recruitment ended), Netherlands (ongoing, recruitment ended), Germany (ongoing, recruitment ended), Bulgaria (ongoing, recruitment ended), Italy (ongoing, recruitment ended).
Therapeutic area(s): Diseases [C] - Virus Diseases [C02]
Gender: Female, Male. Age: 18-64 years, 65+ years. Enrolment: 119.
Status: Ongoing, recruitment ended. Start date (EU): 2022-11-24. Decision date: 2024-09-16. Results received: No. Last updated: 2025-11-20.
Decision dates by country: NL: 2024-09-18, FR: 2024-09-16, DE: 2024-09-24, IT: 2024-10-28, RO: 2024-09-25, BG: 2024-10-04

Condition(s): Chronic Hepatitis D Virus (HDV) Infection
Product: VIR-3434, VIR-2218

Primary endpoint: Proportion of participants with undetectable HDV RNA (< LOD) or ≥ 2 log10 decrease in HDV RNA from baseline and alanine aminotransferase (ALT) normalization (ALT < upper limit of normal [ULN]) at Week 24., Treatment-emergent adverse events (TEAEs) and serious adverse events (SAEs)
Endpoint(s): Proportion of participants with undetectable HDV RNA (< LOD) or ≥ 2 log10 decrease in HDV RNA from baseline and ALT normalization at Week 12, Week 48, Week 72, Week 96, Week 144 and Week 192., Proportion of participants with undetectable HDV RNA (< LOD) or ≥ 2 log10 decrease in HDV RNA from baseline at Week 12, Week 24, Week 48, Week 72, Week 96, Week 144 and Week 192., Proportion of participants with undetectable HDV RNA (< LOD) at Week 12, Week 24, Week 48, Week 72, Week 96, Week 144 and Week 192., Proportion of participants with HDV RNA < lower limit of quantitation (LLOQ) at Week 12, Week 24, Week 48, Week 72, Week 96, Week 144 and Week 192., Change from baseline in HDV RNA at Week 12, Week 24, Week 48, Week 72, Week 96, Week 144 and Week 192., Proportion of participants with ALT normalization at Week 12, Week 24, Week 48, Week 72, Week 96, Week 144 and Week 192., Incidence of ADA and titers of ADA to VIR-3434 at specified study visits up to Week 192 (for cohorts with VIR-3434)., Change from baseline in liver fibrosis at Week 48, Week 96, Week 144, and Week 192., Change from baseline in Model for End Stage Liver Disease (MELD) score at Week 12, Week 24, Week 36, Week 48, Week 60, Week 72, Week 84, Week 96, Week 144, and Week 192., Change from baseline CPT score at Week 24, Week 48, Week 72, Week 96, Week 144, and Week 192.

Source: https://euclinicaltrials.eu/ctis-public/view/2024-512203-40-00